EU clinical trial 2025-521909-40-00: ALTER : A Phase 2, Multicenter, Randomized, Open-label trial assessing sacituzumab-govitecan and trastuzumab-deruxtecan combinaison in an ALTERnating regimen for patients with metastatic or locally advanced Her2-low triple-negative breast Cancer
Protocol code: UC-BCG-2503
Sponsor: Unicancer (Hospital/Clinic/Other health care facility). Phase: Therapeutic exploratory (Phase II). Countries: France (ongoing, recruiting).
Therapeutic area(s): Diseases [C] - Neoplasms [C04]
Gender: Female, Male. Age: 18-64 years, 65+ years. Enrolment: 260.
Status: Ongoing, recruiting. Start date (EU): 2026-01-28. Decision date: 2025-10-23. Results received: No. Last updated: 2026-07-10.

Condition(s): Patients with metastatic or locally advanced HER2-low triple-negative breast cancer and eligible to receive sacituzumab-govitecan and T-Dxd according to their indication.
Product: SACITUZUMAB GOVITECAN, TRASTUZUMAB DERUXTECAN

Primary endpoint: Overall survival estimated by the Kaplan-Meier method will be used as primary efficacy outcome. Overall survival is defined as the interval between the date of randomization and the date of death from any cause. Alive patients will be censored at the date of last follow-up.
Endpoint(s): Efficacy : The clinical benefit rate (CBR), defined as the percentage of patients with a complete response (CR, defined as a disappearance of all target lesions), a partial response (PR, defined as at least a 30% decrease in the sum of diameters of target lesions), or stable disease (SD, defined as neither sufficient shrinkage to qualify for partial response nor sufficient increase to qualify for progressive disease for at least 24 weeks, Efficacy : Objective response rate (ORR), defined as the percentage of patients with a complete response (CR, defined as a disappearance of all target lesions) or a partial response (PR, defined as at least a 30% decrease in the sum of diameters of target lesions)., Efficacy : The progression-free survival (PFS), defined as the interval between the date of randomization and the date of progression or death from any cause, whichever occurs first. A patient alive and without progression will be censored at the date of last follow-up., Efficacy : Quality adjusted PFS (QA-PFS) calculated as the product of the PFS function and the overall health utility index EQ-5D-5L., Safety and Quality of life : Safety and tolerability of sacituzumab govitecan will be evaluated by the frequency and severity of adverse events (AEs), serious adverse events (SAEs), adverse events of special interest (AESIs) graded according to the NCI-CTCAE v5.0; The proportion of treatment discontinuations, interruptions and dose reductions due to any AEs will also be measured., Safety and Quality of life : Mean changes from Baseline in Global Health Status/Quality of Life (GHS/QoL) will be measured at week 24 via the European Organization for Research and Treatment of Cancer Quality of Life Core Questionnaire (EORTC QLQ-C30).

Source: https://euclinicaltrials.eu/ctis-public/view/2025-521909-40-00